EU clinical trial 2022-502938-30-00: A Phase 3 Randomized, Placebo-Controlled, Double-Blind Study to Evaluate Upadacitinib in Adolescent and Adult Subjects with Moderate to Severe Atopic Dermatitis
Protocol code: M16-045
Sponsor: Abbvie Deutschland GmbH & Co. KG (Pharmaceutical company). Phase: Therapeutic confirmatory (Phase III). Countries: France (ended), Estonia (ended), Croatia (ended), Finland (ended), Denmark (ended), Bulgaria (ended), Romania (ended), Germany (ended), Italy (ended).
Therapeutic area(s): Diseases [C] - Immune System Diseases [C20]
Gender: Female, Male. Age: 0-17 years, 18-64 years, 65+ years. Enrolment: 187.
Status: Ended. Start date (EU): 2018-12-10. End date (EU): 2025-07-21. End date: 2025-10-10. Decision date: 2023-07-18. Results received: Yes. Last updated: 2025-03-13.
Decision dates by country: DK: 2023-07-18, EE: 2023-07-24, DE: 2023-08-31, RO: 2023-08-10, HR: 2023-07-20, FR: 2023-07-19, IT: 2023-09-15, FI: 2023-07-20, BG: 2023-08-15

Condition(s): Moderate and Severe Atopic Dermatitis
Product: Placebo for upadacitinib film-coated tablet, Upadacitinib, Upadacitinib

Primary endpoint: Proportion of subjects achieving validated IGA scale for Atopic Dermatitis (vIGA-AD) of 0 or 1 with at least two grades of reduction from baseline at Week 16, Proportion of subjects achieving improvement from baseline of at least 75% on Eczema Area Severity Index (EASI 75) at Week 16.
Endpoint(s): Proportion of subjects achieving an improvement (reduction) in worst pruritus Numerical Rating Scale (NRS) ≥ 4 from Baseline at Week 16 for subjects with pruritus NRS ≥4 at baseline;, Proportion of subjects achieving EASI 90 at Week 16, Percent change from Baseline of worst pruritus NRS at Week 16, Percent change in EASI from Baseline at Week 16, Proportion of subjects achieving an improvement (reduction) in worst pruritus NRS ≥ 4 from Baseline at Week 4 for subjects with pruritus NRS ≥ 4 at Baseline, Proportion of subjects achieving EASI 75 at Week 4, Proportion of subjects achieving EASI 75 at Week 2, Proportion of subjects achieving EASI 90 at Week 4, Proportion of subjects achieving an improvement (reduction) in worst pruritus NRS ≥ 4 from Baseline at Week 1 for subjects with pruritus NRS ≥ 4 at Baseline, Proportion of subjects achieving an improvement (reduction) in Patient Oriented Eczema Measure (POEM) ≥ 4 from Baseline at Week 16 for subjects with POEM ≥ 4 at Baseline, Proportion of subjects age ≥ 16 years old at screening achieving an improvement (reduction) in Dermatology Life Quality Index (DLQI) ≥ 4 from Baseline at Week 16 for subjects with DLQI ≥ 4 at Baseline, Proportion of subjects achieving an improvement (reduction) in worst pruritus NRS ≥ 4 from Baseline at Day 2 for subjects with pruritus NRS ≥ 4 at Baseline (upadacitinib 30 mg vs. placebo), Proportion of subjects achieving an improvement (reduction) in worst pruritus NRS ≥ 4 from Baseline at Day 3 for subjects with pruritus NRS ≥ 4 at Baseline (upadacitinib 15 mg vs. placebo), Proportion of subjects achieving EASI 50 at Week 1, Proportion of subjects experiencing a flare, characterized as a clinically meaningful worsening in EASI, defined as an increase of EASI by ≥ 6.6 from Baseline, during double-blind treatment period (DB Period), Proportion of subjects age ≥ 16 years old at screening achieving DLQI score of 0 or 1 at Week 16, Percent change in Scoring Atopic Dermatitis (SCORAD) from Baseline at Week 16, Change from Baseline in Hospital Anxiety and Depression Scale (HADS) total score at Week 16, Proportion of subjects achieving a Hospital Anxiety and Depression Scale-anxiety (HADS-A) < 8 and Hospital Anxiety and Depression Scale depression (HADS-D) < 8 at Week 16 among subjects with HADS-A ≥ 8 or HADS-D ≥ 8 at Baseline, Proportion of subjects achieving an improvement (reduction) in Atopic Dermatitis Impact Scale (ADerm-IS) sleep domain score ≥ minimal clinically important difference (MCID) from Baseline at Week 16 for subjects with ADerm-IS sleep domain score ≥ MCID at Baseline, Proportion of subjects achieving an improvement (reduction) in Atopic Dermatitis Symptom Scale (ADerm-SS) skin pain score ≥ MCID from Baseline at Week 16 for subjects with ADerm-SS skin pain score ≥ MCID at Baseline, Proportion of subjects achieving an improvement (reduction) in ADerm-SS 7-item total symptom score (TSS-7) ≥ MCID from Baseline at Week 16 for subjects with ADerm TSS-7 ≥ MCID at Baseline; ADerm-SS TSS-7 is defined as the algebraic sum of the responses to items 1 – 7 of the ADerm-SS, Proportion of subjects achieving an improvement (reduction) in ADerm-IS emotional state domain score ≥ MCID from Baseline at Week 16 for subjects with ADerm-IS emotional state domain score ≥ MCID at Baseline, Proportion of subjects achieving an improvement (reduction) in ADerm-IS daily activities domain score ≥ MCID from Baseline at Week 16 for subjects with ADerm-IS daily activities domain score ≥ MCID at Baseline, Proportion of subjects achieving EASI 100 at Week 16, Proportion of subjects achieving an improvement (reduction) in ADerm-SS TSS-7 ≥ MCID from Baseline at Week 4 for subjects with ADerm-SS TSS-7 ≥ MCID at Baseline, Proportion of subjects achieving an improvement (reduction) in ADerm-IS sleep domain score ≥ MCID from Baseline at Week 4 for subjects with ADerm-IS sleep domain score ≥ MCID at Baseline, Proportion of subjects achieving a vIGA-AD of 0 with a reduction from Baseline of ≥ 2 points at Week 16

Source: https://euclinicaltrials.eu/ctis-public/view/2022-502938-30-00